EU clinical trial 2022-503062-72-00: Phase 2, Double-Blind, Randomized, Placebo-Controlled, Dose-Ranging, Efficacy, and Safety Study of Povorcitinib in Participants With Chronic Spontaneous Urticaria
Protocol code: INCB 54707-207
Sponsor: Incyte Corp. (Pharmaceutical company). Phase: Therapeutic exploratory (Phase II). Countries: Germany (ended), Poland (ended).
Therapeutic area(s): Diseases [C] - Skin and Connective Tissue Diseases [C17]
Gender: Female, Male. Age: 18-64 years, 65+ years. Enrolment: 66.
Status: Ended. Start date (EU): 2023-11-23. End date (EU): 2025-10-02. End date: 2025-10-09. Decision date: 2023-10-31. Results received: No. Last updated: 2025-10-02.
Decision dates by country: PL: 2023-11-06, DE: 2023-10-31

Condition(s): Chronic Spontaneous Urticaria
Product: Povorcitinib matching placebo., Povorcitinib

Primary endpoint: Change from baseline in the UAS7, defined as the 7-day sum of the individual, daily recorded scores for HSS and ISS, at Week 12.
Endpoint(s): Proportion of participants who achieve UAS7 ≤ 6 (controlled disease) at Week 12., Time to first achievement of UAS7 ≤ 6 (controlled disease) during the PC period., Proportion of participants with UAS7 = 0 at Week 12.

Source: https://euclinicaltrials.eu/ctis-public/view/2022-503062-72-00